EU clinical trial 2023-507937-14-00: PHASE 1/2, OPEN-LABEL, MULTICENTER, FIRST IN-HUMAN STUDY OF DS-3939a IN SUBJECTS WITH ADVANCED SOLID TUMORS
Protocol code: DS3939-077
Sponsor: Daiichi Sankyo Inc. (Pharmaceutical company). Phase: Phase I and Phase II (Integrated)- First administration to humans. Countries: France (ongoing, recruiting), Spain (ongoing, recruiting), Belgium (ongoing, recruiting).
Therapeutic area(s): Diseases [C] - Neoplasms [C04]
Gender: Female, Male. Age: 18-64 years, 65+ years. Enrolment: 207.
Status: Ongoing, recruiting. Start date (EU): 2025-03-25. Decision date: 2024-10-11. Results received: No. Last updated: 2026-02-19.
Decision dates by country: BE: 2024-10-11, ES: 2024-10-15, FR: 2024-10-11

Condition(s): Metastatic Solid Tumor, Advanced Solid Tumor
Product: DS-3939a

Primary endpoint: Dose-limiting Toxicities (DLTs) [Part 1 only], Treatmentemergent Adverse Events (TEAEs), Laboratory findings, electrocardiogram (ECG), vital signs, echocardiogram or multigated acquisition (ECHO/MUGA) findings, physical examination results, Objective Response Rate (ORR) [Part 2 only]
Endpoint(s): Objective Response Rate (ORR) [Part 1 only], Disease Control Rate (DCR), Duration of Response (DoR), Time to Response (TTR), Progression Free Survival (PFS), Overall Survival (OS), TA-MUC1 Expression by Immunohistochemistry (IHC), Plasma PK parameters (eg, AUClast, AUCtau, Cmax, Tmax, Ctrough, and t1/2) of total conjugated payload, total anti-TAMUC1 antibody, and free payload, Anti-drug Antibodies (ADAs) for DS-3939a (status and titers) at Baseline and on treatment

Source: https://euclinicaltrials.eu/ctis-public/view/2023-507937-14-00